EU clinical trial 2024-518763-35-00: Maintenance Therapy of the Effects of Donepezil-iGaLa Combined Therapy in Post-Stroke Chronic Aphasia: Identification of Predictive Biomarkers of Efficacy.
Protocol code: Don-iGALA
Sponsor: Fundacion Publica Andaluza Para La Investigacion De Malaga En Biomedicina Y Salud (Laboratory/Research/Testing facility). Phase: Therapeutic confirmatory (Phase III). Countries: Spain (not authorised).
Therapeutic area(s): Diseases [C] - Nervous System Diseases [C10]
Gender: Female, Male. Age: 18-64 years, 65+ years. Enrolment: 12.
Status: Not authorised. Decision date: 2025-02-25. Results received: No. Last updated: 2025-02-25.

Condition(s): Chronic post-stroke aphasia.

Source: https://euclinicaltrials.eu/ctis-public/view/2024-518763-35-00